EU clinical trial 2024-513562-19-00: A Study to Evaluate the Efficacy and Safety of XyloCore, a Glucose Sparing Experimental Solution, for Peritoneal Dialysis (ELIXIR)
Protocol code: IP-001-18
Sponsor: Iperboreal Pharma S.r.l. (Pharmaceutical company). Phase: Therapeutic confirmatory (Phase III). Countries: Sweden (ongoing, recruiting), Spain (ongoing, recruiting), Germany (ongoing, recruitment ended), Denmark (ended), Italy (ongoing, recruiting).
Therapeutic area(s): Diseases [C] - Male Urogenital Diseases [C12]
Gender: Female, Male. Age: 18-64 years, 65+ years. Enrolment: 160.
Start date (EU): 2023-08-30. Decision date: 2024-07-03. Results received: No. Last updated: 2026-06-03.
Decision dates by country: SE: 2024-07-03, DE: 2024-07-03, DK: 2024-07-03, IT: 2024-08-05, ES: 2024-07-08

Condition(s): End-Stage Kidney Disease
Product: bicaVera 1,5 % Glucose, 1,75 mmol/l Calcium, Peritonealdialyselösung, equiBalance 2,3% glucosio, 1,75 mmol/l calcio, soluzione per dialisi peritoneale, PHYSIONEAL 35 Glucose 3,86 % w/v / 38,6 mg/ml, Peritonealdialyselösung, PHYSIONEAL 40 Glucose 2,27 % w/v / 22,7 mg/ml, Peritonealdialyselösung, balance 4,25% Glucose, 1,25 mmol/l Calcium, Peritonealdialyselösung, FIXIONEAL “35 Glucosio 2,27% p/v/22,7 mg/ml” in sacca Clear-Flex, Soluzione per dialisi peritoneale, PHYSIONEAL 35 Glucose 1,36 % w/v / 13,6 mg/ml, Peritonealdialyselösung, Xylocore Medium Strength, PHYSIONEAL 35 Glucose 2,27 % w/v / 22,7 mg/ml, Peritonealdialyselösung, Xylocore High Strength, PHYSIONEAL 40 Glucose 1,36 % w/v / 13,6 mg/ml, Peritonealdialyselösung, bicaVera 1,5 % Glucose, 1,25 mmol/l Calcium Peritonealdialyselösung, bicaVera 2,3 % Glucose, 1,25 mmol/l Calcium Peritonealdialyselösung, balance 1,5% Glucose, 1,75 mmol/l Calcium, Peritonealdialyselösung, equiBalance 1,5% glucosio, 1,75 mmol/l calcio, soluzione per dialisi peritoneale, PHYSIONEAL 40 Glucose 3,86 % w/v / 38,6 mg/ml, Peritonealdialyselösung, FIXIONEAL “35 Glucosio 3,86% p/v/38,6 mg/ml” in sacca Clear-Flex Soluzione per dialisi peritoneale, balance 2,3% Glucose, 1,75 mmol/l Calcium, Peritonealdialyselösung, balance 4,25% Glucose, 1,75 mmol/l Calcium, Peritonealdialyselösung, bicaVera 4,25 % Glucose, 1,75 mmol/l Calcium, Peritonealdialyselösung, bicaVera 2,3 % Glucose, 1,75 mmol/l Calcium, Peritonealdialyselösung, Xylocore Low Strength, balance 2,3% Glucose, 1,25 mmol/l Calcium, Peritonealdialyselösung, equiBalance 4,25% glucosio, 1,75 mmol/l calcio, soluzione per dialisi peritoneale, balance 1,5% Glucose, 1,25 mmol/l Calcium, Peritonealdialyselösung, FIXIONEAL “35 Glucosio 1,36% p/v / 13,6 mg/ml” in sacca Clear-Flex, Soluzione per dialisi peritoneale, Dianeal PDG4 1,36 % , Peritonealdialyselösung, Dianeal PDG4 2,27 % , Peritonealdialyselösung, Dianeal PDG4 3,86 % , Peritonealdialyselösung, bicaVera 4,25 % Glucose, 1,25 mmol/l Calcium Peritonealdialyselösung

Primary endpoint: Weekly Kt/V urea (V1, V3, V4, V5)
Endpoint(s): Glycemic and lipid metabolic parameters: LDL, HDL and total cholesterol, serum triglycerides, insulin (V1, V3, V4, V5), EPO requirements (V1, V3, V5), Patients’ subjective assessment of fatigue (V1, V3, V5), 24h peritoneal dialysate analysis: volume, ultrafiltration, urea, creatinine (V1, V3, V4, V5), 24h urine analysis: volume, urea, creatinine (V1, V3, V4, V5), Residual Kidney Function (V1, V3, V4, V5), Safety, evaluated by physical examinations, vital signs, laboratory outcomes and adverse events (whole study)

Source: https://euclinicaltrials.eu/ctis-public/view/2024-513562-19-00